EU clinical trial 2024-514871-17-00: A DOUBLE-BLIND, RANDOMIZED, PLACEBO-CONTROLLED, SINGLE AND MULTIPLE ASCENDING DOSE PHASE 1 STUDY TO INVESTIGATE THE SAFETY, TOLERABILITY, PHARMACOKINETIC, AND PHARMACODYNAMIC PROFILE OF RES-010 IN HEALTHY, OVERWEIGHT, AND MODERATELY OBESE SUBJECTS
Protocol code: RES-010-001
Sponsor: Resalis Therapeutics S.r.l. (Pharmaceutical company). Phase: Human Pharmacology (Phase I)- First administration to humans. Countries: Netherlands (ended).
Therapeutic area(s): Diseases [C] - Nutritional and Metabolic Diseases [C18]
Gender: Female, Male. Age: 18-64 years. Enrolment: 80.
Status: Ended. Start date (EU): 2024-10-29. End date (EU): 2026-04-21. Decision date: 2024-10-08. Results received: No. Last updated: 2026-02-25.
Decision dates by country: NL: 2024-11-22

Condition(s): Obesity

Source: https://euclinicaltrials.eu/ctis-public/view/2024-514871-17-00